EU clinical trial 2022-500143-21-01: Screening and intervention for subclinical coronary artery disease in patients with type 2 diabetes: THE STENO INTEN-CT STUDY
Protocol code: INTEN-CT
Sponsor: Aarhus University Hospital, Odense University Hospital (Hospital/Clinic/Other health care facility). Phase: Therapeutic use (Phase IV). Countries: Denmark (ongoing, recruitment ended).
Therapeutic area(s): Diseases [C] - Cardiovascular Diseases [C14]
Gender: Female, Male. Age: 18-64 years, 65+ years. Enrolment: 7300.
Status: Ongoing, recruitment ended. Start date (EU): 2023-01-12. Decision date: 2022-07-08. Results received: No. Last updated: 2024-09-20.

Condition(s): Type 2 diabetes
Product: Ozempic 1 mg solution for injection in pre-filled pen, Ozempic 0.25 mg solution for injection in pre-filled pen, Nitrolingual Pumpspray 400 micrograms per metered dose, sublingual spray., Ivabradin Medical Valley 5 mg filmdragerade tabletter, Forxiga 10 mg film-coated tablets, Iomeron 350 mg I/ml injektionsvätska, lösning, Seloken 1 mg/ml injektionsvätska, lösning, Atenolol Orifarm 50 mg tabletter, Ozempic 0.5 mg solution for injection in pre-filled pen

Primary endpoint: Rates of a composite cardiovascular endpoint (cardiovascular death, non-fatal myocardial infarction, hospitalization for heart failure, non-fatal stroke and revascularization of peripheral artery disease).
Endpoint(s): Separate cardiovascular endpoints, all-cause mortality, and renal failure., Patient reported outcomes (EQ-5D questionnaire), Quality adjusted life years (QALY) using data from the EQ-5D questionnaire and Danish preference weights of the normal population. Register-based rates of procedural codes encompassing tests for atherosclerosis/ischemia of the heart, brain or peripheral circulation and register-based rates of prescription of drugs used in CVD prophylaxis (glucose-lowering drugs, antihypertensive drugs, lipid-lowering drugs and antithrombotic drugs).

Source: https://euclinicaltrials.eu/ctis-public/view/2022-500143-21-01